EU clinical trial 2025-524031-39-00: Phase I study of CDK8 inhibitor RVU120 in combination with everolimus in children with recurrent or progressive Group 3 or 4 medulloblastoma; MEDWAY
Protocol code: MEDWAY
Sponsor: Instytut Pomnik Centrum Zdrowia Dziecka (Hospital/Clinic/Other health care facility). Phase: Human Pharmacology (Phase I)- Other. Countries: Poland (authorised, recruitment pending).
Therapeutic area(s): Diseases [C] - Nervous System Diseases [C10]; Diseases [C] - Neoplasms [C04]
Gender: Female, Male. Age: 0-17 years. Enrolment: 48.
Status: Authorised, recruitment pending. Decision date: 2026-04-23. Results received: No. Last updated: 2026-07-30.

Condition(s): Medulloblastoma (recurrent or progressive)
Product: SEL120 monohydrochloride, Votubia 2.5 mg tablets, Certican, 0,5 mg, tabletki, SEL120 monohydrochloride, Votubia 5 mg tablets

Primary endpoint: 1. Frequency and nature of AEs, SAEs and DLTs according to CTCAE v5.0 in RVU120 monotherapy and combination therapy with everolimus 2. MTD and/or RP2D of RVU120 as a single agent and in combination with everolimus
Endpoint(s): 1. PK parameters of RVU120 as a single agent and in combination with everolimus, including Cmax, AUCτ, tmax, AUC0 - ∞, t1/2 2. Ctrough of everolimus in combination with RVU120 3. Overall response rate (ORR), duration of response, progression-free survival (PFS), and overall survival (OS) in accordance with RAPNO guidelines, where applicable, stratified by molecular subgroup (G3 vs. G4) and MYC or MYCN expression in combination therapy of RVU120 and everolimus

Source: https://euclinicaltrials.eu/ctis-public/view/2025-524031-39-00